EU clinical trial 2023-506788-32-00: Study of Abemaciclib with Pembrolizumab in Patients with Stage IV Lung Cancer or Breast Cancer
Protocol code: I3Y-MC-JPCE
Sponsor: Eli Lilly & Co. (Pharmaceutical company). Phase: Human Pharmacology (Phase I)- Bioequivalence Study. Countries: Belgium (ongoing, recruitment ended).
Therapeutic area(s): Diseases [C] - Neoplasms [C04]
Gender: Female, Male. Age: 18-64 years, 65+ years. Enrolment: 1.
Status: Ongoing, recruitment ended. Start date (EU): 2016-11-15. Decision date: 2024-03-20. Results received: No. Last updated: 2025-12-19.

Condition(s): Lung Cancer or Breast Cancer

Source: https://euclinicaltrials.eu/ctis-public/view/2023-506788-32-00